EU clinical trial 2024-514343-29-00: Randomized, double-blind, Phase 3 study comparing efficacy and safety of frexalimab (SAR441344) to teriflunomide in adult participants with relapsing forms of multiple sclerosis
Protocol code: EFC17919B
Sponsor: Sanofi-Aventis Recherche & Developpement (Pharmaceutical company). Phase: Therapeutic confirmatory (Phase III). Countries: Germany (ongoing, recruitment ended), Bulgaria (ongoing, recruitment ended), Czechia (ongoing, recruitment ended), Hungary (ongoing, recruitment ended), Italy (ongoing, recruitment ended), Romania (ended), Greece (ongoing, recruitment ended), Slovakia (ongoing, recruitment ended), Austria (ongoing, recruitment ended), France (ongoing, recruitment ended), Lithuania (ongoing, recruitment ended), Poland (ongoing, recruitment ended), Portugal (ongoing, recruitment ended), Denmark (ongoing, recruitment ended), Croatia (ended), Spain (ongoing, recruitment ended).
Therapeutic area(s): Diseases [C] - Nervous System Diseases [C10]
Gender: Female, Male. Age: 18-64 years. Enrolment: 410.
Start date (EU): 2024-11-19. Decision date: 2024-10-22. Results received: No. Last updated: 2026-07-02.
Decision dates by country: BG: 2024-10-28, DK: 2024-10-22, HU: 2024-10-22, ES: 2024-10-23, DE: 2024-10-28, SK: 2024-10-28, GR: 2024-10-22, AT: 2024-10-23, RO: 2024-10-28, HR: 2024-10-28, FR: 2024-10-25, PL: 2024-10-28, LT: 2024-10-23, CZ: 2024-10-23, IT: 2024-10-23, PT: 2024-10-28

Condition(s): multiple sclerosis
Product: Matched placebo for comparator teriflunomide, AUBAGIO 14 mg film-coated tablets, AUBAGIO 14 mg film-coated tablets, Matched placebo for test product frexalimab, AUBAGIO 14 mg film-coated tablets, Frexalimab, COLESTYRAMINE, AUBAGIO 14 mg film-coated tablets, AUBAGIO 14 mg film-coated tablets

Primary endpoint: Annualized relapse rate (ARR) during the study period assessed by protocol defined adjudicated relapses
Endpoint(s): Time to onset of composite confirmed disability worsening (cCDW), Time to onset of cCDW, confirmed over 3 months, Time to onset of individual components of the composite, confirmed over 3-months or 6-months, Time to onset of confirmed disability improvement (CDI), Progression independent of relapse activity defined as the time to onset of 6-month cCDW, Total number of new and/or enlarging T2 hyperintense lesions as detected by MRI, Total number of new Gd-enhancing T1 hyperintense lesions per scan as detected by MRI, Percent change in brain volume loss as detected by brain MRI scans at the EOS compared to Month 6, Change in cognitive function at the EOS compared to baseline as assessed by the symbol digit modalities test (SDMT), Change from baseline in multiple sclerosis impact scale 29 version 2 (MSIS-29v2) questionnaire scores over time, Change from baseline in patient reported outcome measurement information system (PROMIS) Fatigue MS-8 over time, Adverse events, SAEs, AEs leading to permanent study intervention discontinuation, AESIs, safety scales, and potentially clinically significant abnormality (PCSAs) in laboratory tests, ECG, and vital signs during the study period, Antidrug antibodies (ADAs) over time, Change from baseline in plasma neurofilament light chain (NfL) levels over time, Frexalimab plasma concentration over time

Source: https://euclinicaltrials.eu/ctis-public/view/2024-514343-29-00